EU clinical trial 2024-513307-13-00: REJOICE-PanTumor01: A Phase 2, Multicenter, Open-Label, Pan-Tumor Trial to Evaluate Efficacy and Safety of Raludotatug Deruxtecan (R-DXd) in Participants with Advanced/Metastatic Solid Tumors
Protocol code: DS6000-126
Sponsor: Daiichi Sankyo Inc. (Pharmaceutical company). Phase: Therapeutic exploratory (Phase II). Countries: Italy (ongoing, recruitment ended), France (ongoing, recruitment ended), Belgium (ongoing, recruitment ended), Spain (ongoing, recruitment ended), Denmark (ongoing, recruitment ended).
Therapeutic area(s): Diseases [C] - Neoplasms [C04]
Gender: Female, Male. Age: 18-64 years, 65+ years. Enrolment: 73.
Status: Ongoing, recruitment ended. Start date (EU): 2025-05-26. Decision date: 2025-03-24. Results received: No. Last updated: 2026-02-17.
Decision dates by country: BE: 2025-03-25, DK: 2025-04-09, ES: 2025-03-24, IT: 2025-03-26, FR: 2025-03-28

Condition(s): Advanced/metastatic solid tumors including gynecological cancers (endometrial cancer, cervical cancer, and nonhigh- grade serous ovarian cancer) and genitourinary cancers (urothelial cancer and ccRCC)
Product: Raludotatug Deruxtecan

Primary endpoint: For all cohorts except ccRCC: ORR is defined as the proportion of participants with a BOR of confirmed CR or confirmed PR according to RECIST version 1.1 criteria.For ccRCC cohort only: DCR is defined as the proportion of participants who achieved a BOR of confirmed CR, confirmed PR, or stable disease (maintained for ≥5 weeks) according to RECIST version 1.1. Incidence of TEAEs, SAEs, AESIs

Source: https://euclinicaltrials.eu/ctis-public/view/2024-513307-13-00